EU clinical trial 2024-514855-13-00: An open label phase II basket trial exploring the efficacy and safety of the combination of Niraparib and Dostarlimab in patients with DNA repair-deficient or platinum-sensitive solid tumors (NIRADO)
Protocol code: 2020/3093 NIRADO
Sponsor: Institut Gustave Roussy (Hospital/Clinic/Other health care facility). Phase: Therapeutic exploratory (Phase II). Countries: France (ended).
Therapeutic area(s): Diseases [C] - Neoplasms [C04]
Gender: Female, Male. Age: 18-64 years, 65+ years. Enrolment: 112.
Status: Ended. End date (EU): 2025-02-25. Decision date: 2024-07-09. Results received: No. Last updated: 2024-07-09.

Condition(s): DNA repair-deficient or platinum-sensitive solid tumors
Product: JEMPERLI 500 mg concentrate for solution for infusion, Zejula 100 mg film-coated tablets

Primary endpoint: Overall Response Rate (ORR) at 15 weeks according to Response Evaluation Criteria In Solid Tumors v1.1 (RECIST v1.1).
Endpoint(s): Overall Reponse Rate (ORR) at 21 weeks according to RECIST v1.1, Overall response rate (ORR) at 15 and 21 weeks according to iRECIST., Best overall response (BOR) according to RECIST v1.1, Duration of response (DOR) according to RECIST v1.1, Progression-free survival (PFS) according to RECIST v1.1, Time to tumor progression (TTP) according to RECIST v1.1, iTTP according iRECIST, iPFS according to iRECIST, Best overall response (iBOR) according to iRECIST, Duration of response (iDOR) according to iRECIST., Disease control rate (DCR) according to RECIST v1.1 and iRECIST, Maximum percentage of shrinkage from baseline in the sum of the reference diameters of the target lesions (selected according to RECIST and iRECIST), Overall Survival, Safety according to CTCAE v. 5.0, Quality of life according to EORTC-QLQ30

Source: https://euclinicaltrials.eu/ctis-public/view/2024-514855-13-00